EU clinical trial 2023-509028-17-00: An Open Label Study to Evaluate the Long-term Safety and Efficacy of Odevixibat (A4250) in Patients with Alagille Syndrome (ASSERT-EXT)
Protocol code: A4250-015
Sponsor: Ipsen Pharma (Pharmaceutical company). Phase: Therapeutic confirmatory (Phase III). Countries: Poland (ongoing, recruitment ended), France (ended), Belgium (ended), Netherlands (ended), Italy (ended), Germany (ongoing, recruitment ended).
Therapeutic area(s): Diseases [C] - Congenital, Hereditary, and Neonatal Diseases and Abnormalities [C16]
Gender: Female, Male. Age: 0-17 years, 18-64 years. Enrolment: 35.
Start date (EU): 2022-01-06. Decision date: 2024-02-07. Results received: No. Last updated: 2026-06-11.
Decision dates by country: BE: 2024-02-19, NL: 2024-02-07, FR: 2024-02-19, DE: 2024-03-05, PL: 2024-02-21, IT: 2024-02-14

Condition(s): Alagille Syndrome
Product: KAYFANDA 1 200 microgram hard capsules, KAYFANDA 200 microgram hard capsules, KAYFANDA 400 microgram hard capsules, KAYFANDA 600 microgram hard capsules

Primary endpoint: Change from baseline in scratching through Week 72 as measured by the Albireo ObsRO caregiver instrument.
Endpoint(s): • Change in serum bile acid levels from baseline to Week 72;, • Change from baseline through Week 72 in patient reported and observer reported itching and scratching severity scores, respectively, for the morning and evening assessment;, • Percentage of patients achieving a clinically meaningful decrease in pruritus (pruritus responders) at each visit as measured by the Albireo ObsRO/patient reported outcomes (PRO) instruments;, • Change from baseline to Week 72 in sleep parameters as measured with the Albireo ObsRO/PRO instruments (e.g. tiredness and number of awakenings);, • Change from baseline to Week 72 in Pediatric Quality of Life Inventory (PedsQL) scores, • Assessment of Global Symptom Relief from baseline to Weeks 4, 12, 24, 48, and 72 as measured by patient, caregiver, and clinician Global impression of Symptoms (PGIS, CaGIS, CGIS) items, • Assessment of Global Symptom Relief as measured by patient, caregiver, and clinician Global Impression of Change (PGIC, CaGIC, CGIC) items at Weeks 4, 12, 24, 48, and 72, • Change in serum bile acid levels from baseline through Week 72

Source: https://euclinicaltrials.eu/ctis-public/view/2023-509028-17-00